EU clinical trial 2023-510163-35-00: Utility of the use of N-acetylcysteine associated with conventional treatment in patients with severe acute alcoholic hepatitis (Maddrey>=32)
Protocol code: CONACHAA
Sponsor: Asociacion Instituto De Investigacion Sanitaria Bioaraba (Laboratory/Research/Testing facility). Phase: Therapeutic confirmatory (Phase III). Countries: Spain (authorised, recruitment pending).
Therapeutic area(s): Diseases [C] - Digestive System Diseases [C06]
Gender: Female, Male. Age: 18-64 years, 65+ years. Enrolment: 180.
Status: Authorised, recruitment pending. Decision date: 2025-01-15. Results received: No. Last updated: 2025-01-15.

Condition(s): Acute Alcoholic hepatitis
Product: METHYLPREDNISOLONE, ACETYLCYSTEINE

Primary endpoint: To assess the efficacy of the use of methylprednisolone + NAC, in terms of 1 month mortality, in patients with Severe Acute Alcoholic Hepatitis
Endpoint(s): To assess mortality at three months and six months, To assess liver complications, infections and renal failure, To assess the tolerance to NAC, To assess the relationship between the Lille index at day 7 and the response to treatment

Source: https://euclinicaltrials.eu/ctis-public/view/2023-510163-35-00